EU clinical trial 2025-520959-90-00: Role of the noradrenergic system in the regulation of learning dynamics: evaluation of the effect of a low-dose selective noradrenaline reuptake inhibitor (NOISYXETINE)
Protocol code: D24-P017
Sponsor: Groupe Hospitalier Universitaire Paris Psychiatrie Et Neuroscience (Hospital/Clinic/Other health care facility). Phase: Therapeutic exploratory (Phase II). Countries: France (authorised, recruiting).
Therapeutic area(s): Psychiatry and Psychology [F] - Psychological Phenomena [F02]
Gender: Female, Male. Age: 18-64 years. Enrolment: 176.
Status: Authorised, recruiting. Start date (EU): 2025-11-18. Decision date: 2025-06-26. Results received: No. Last updated: 2026-01-12.

Condition(s): Healthy subjects with no neurological or psychiatric disorders
Product: Atomoxetin STADA 40 mg Hartkapseln, GELATIN

Primary endpoint: The primary evaluation criterion is the paired difference in the parameters of the computational models that characterize the learning process (in a stable accumulation task and in a dynamic accumulation task), between the sNRI (atomoxetine) and control (placebo) conditions
Endpoint(s): Continued EEG recording during the neuropsychological tests at V1 and V2, and its correlation with different latent variables of the learning process, between the atomoxetine and placebo conditions, Paired differences in the pupil diameter recorded using an eye-tracking device, and its correlation with different latent variables of the learning process, between the atomoxetine and placebo conditions, Paired differences in ECG, and its correlation with different latent variables of the learning process, between the atomoxetine and placebo conditions during the neuropsychological tests, Paired difference in salivary cortisol concentration as an indirect marker of noradrenaline function between the atomoxetine and placebo condition, Psychometric scales at the end of the neuropsychological tests at V1 and V2: • State Trait Anxiety Inventory (STAI) - to measure anxiety levels, • Beck Depression Inventory (BDI) - to measure the level of depression (Beck et al., 1996), • Visual Analog Scales (VAS) for intensity of anxiety, sadness and fatigue, Side effects in all groups between study drug administration (D0) and V2 including vital signs worsening and ECG findings, Genotyping for 3 SNPs in genes assumed to affect noradrenergic function: ADRA2 (rs1800544) and two of the NET (rs28386840, rs2242446)

Source: https://euclinicaltrials.eu/ctis-public/view/2025-520959-90-00